EU clinical trial 2024-515535-30-00: A study of different dose levels of FluBHPVE6E7 or placebo in women infected with the virus Human Papilloma Type 16 (HPV 16).
Protocol code: BS-02
Sponsor: Bluesky Immunotherapies GmbH (Pharmaceutical company). Phase: Human Pharmacology (Phase I)- Other. Countries: Slovakia (ongoing, recruiting).
Therapeutic area(s): Diseases [C] - Female Urogenital Diseases and Pregnancy Complications [C13]
Gender: Female. Age: 18-64 years. Enrolment: 20.
Status: Ongoing, recruiting. Start date (EU): 2023-06-22. Decision date: 2024-09-20. Results received: No. Last updated: 2025-04-10.

Condition(s): Treatment of human papilloma virus (HPV) associated infections, precancers and cancers

Source: https://euclinicaltrials.eu/ctis-public/view/2024-515535-30-00